EU clinical trial 2024-516671-33-00: A prospective, multicenter, randomised, double-blind, placebo-controlled, parallel groups, phase 3 study to compare the efficacy and safety of masitinib in combination with Riluzole versus placebo in combination with Riluzole in the treatment of patients suffering from Amyotrophic Lateral Sclerosis (ALS)
Protocol code: AB19001
Sponsor: Ab Science (Pharmaceutical company). Phase: Therapeutic confirmatory (Phase III). Countries: Sweden (ended), Norway (temporarily halted), France (temporarily halted), Denmark (temporarily halted), Greece (temporarily halted).
Therapeutic area(s): Diseases [C] - Nervous System Diseases [C10]
Gender: Female, Male. Age: 18-64 years, 65+ years. Enrolment: 155.
Start date (EU): 2021-05-24. Decision date: 2025-01-30. Results received: No. Last updated: 2026-02-09.
Decision dates by country: DK: 2025-01-31, NO: 2025-02-03, FR: 2025-01-30, GR: 2025-01-31, SE: 2025-01-31

Condition(s): Amyotrophic Lateral Sclerosis
Product: masitinib, Placebo to 200mg masitinib, Placebo to 100mg masitinib, masitinib

Primary endpoint: Absolute change from baseline at week 48 in ALSFRS-R score will be analysed using multiple imputation model.
Endpoint(s): - PFS will be analysed using the log rank test. Kaplan-Meier Plots will be provided., - ALSAQ-40 change will be analyzed using the same primary model. In addition, an Analysis of Covariance model (ANCOVA) with stratification factors, treatment and baseline ALSAQ-40 score will be performed., - FVC change from baseline will be analysed using the same model as primary. In addition, an ANCOVA with stratification factors, treatment and baseline ALSAQ-40 score will be performed., - Upper- and lower-limb muscle strength using HHD will be summarized by treatment arm., - Clinician-rated CGI will be summarized by treatment arm., - CAFS will be analysed using the Generalised GehanWilcoxon rank test., - OS will be analysed using the log rank test. Kaplan-Meier Plots will be provided., - EFS will be analysed using the log rank test. Kaplan-Meier Plots will be provided., - Safety: Occurrence of Adverse Events (AE), changes on physical examination, vital signs (blood pressure, heart rate, weight and temperature), ECG and clinical laboratory tests (haematology, biochemistry, urinalysis, urinary cytology)

Source: https://euclinicaltrials.eu/ctis-public/view/2024-516671-33-00